EU clinical trial 2024-517308-13-00: Early oral step-down antibiotic therapy versus continuing intravenous therapy for uncomplicated Gram-negative bacteraemia (the INVEST trial)
Protocol code: DSRB 2021/00764
Sponsor: Tan Tock Seng Hospital Pte. Ltd. (Hospital/Clinic/Other health care facility). Phase: Therapeutic use (Phase IV). Countries: Spain (ongoing, recruitment ended), Italy (ongoing, recruitment ended), Greece (ended).
Therapeutic area(s): Diseases [C] - Bacterial Infections and Mycoses [C01]
Gender: Female, Male. Age: 18-64 years, 65+ years. Enrolment: 160.
Start date (EU): 2025-12-10. Decision date: 2025-04-30. Results received: No. Last updated: 2026-03-17.
Decision dates by country: ES: 2025-04-30, IT: 2025-07-17, GR: 2025-11-10

Condition(s): Gram-negative bacteraemia
Product: LEVOFLOXACIN, TRIMETHOPRIM, FOSFOMYCIN, AMIKACIN, SULFAMETHOXAZOLE AND TRIMETHOPRIM

Primary endpoint: Compare the all-cause mortality at day 30 post-randomisation in patients from the standard arm versus intervention arm.
Endpoint(s): Compare between standard and intervention arms: All-cause mortality at days 14 and 90 from the time of randomisation, Duration of survival from the time of randomisation until day 90, Number of days on IV antibiotic therapy in the total index hospitalisation (including outpatient parenteral antibiotic therapy [OPAT]) for surviving participants from the time of randomisation until i. hospital discharge and ii. day 90, Number of days alive and free of antibiotics (i. for all antibiotics and ii. for IV antibiotics) between the time of randomisation and day 90, Adverse events from the time of randomisation until day 90 including: C. difficile-associated diarrhoea Peripherally inserted central catheter and other central venous catheter complications requiring line removal during index hospitalisation from the time of randomisation Liver function test abnormalities or kidney injury, Change in treatment strategy (e.g. switch to IV antibiotics from allocated oral antibiotics or vice versa) between the time of randomisation and day 30 due to: An adverse event deemed by the treating doctor to be of sufficient severity to change treatment strategy Presumed lack of efficacy of treatment strategy according to the judgement of treating doctor, Time to being discharged alive from the total index hospitalisation (including OPAT and hospital in the home) between the time of randomisation and day 90 (note: any death occurrence within 90 days will be considered ‘90 days’), Number of days alive and not in hospital (including OPAT) between the time of randomisation and day 90, Readmission or extended hospitalisation by day 90. Readmission is defined as a new hospitalisation for any cause or a return to ambulatory hospital services occurring after discharge from the index hospitalisation. Extended hospitalisation is defined as >14 days of hospital LOS starting from the day of randomisation., Health economic evaluation, including estimation of total healthcare cost (from healthcare system and patient perspective)* and assessment of patient’s quality of life via EQ-5D by day 90 *Cost savings/effectiveness analyses will be performed in selected hospital sites

Source: https://euclinicaltrials.eu/ctis-public/view/2024-517308-13-00